EU clinical trial 2024-514666-39-00: Phase 2 trial of Translational approach to first line cHemoimmunotherapy followed by maintenance with pembrOlizumab and olaparib in Extensive-Stage Small-Cell Lung CanceR (THOR trial)
Protocol code: IRST162.14
Sponsor: Istituto Romagnolo Per Lo Studio Dei Tumori Dino Amadori IRST S.r.l. (Hospital/Clinic/Other health care facility). Phase: Therapeutic exploratory (Phase II). Countries: Italy (ongoing, recruiting).
Therapeutic area(s): Diseases [C] - Neoplasms [C04]; Diseases [C] - Respiratory Tract Diseases [C08]
Gender: Female, Male. Age: 18-64 years, 65+ years. Enrolment: 60.
Status: Ongoing, recruiting. Start date (EU): 2023-03-16. Decision date: 2024-07-16. Results received: No. Last updated: 2026-05-12.

Condition(s): Extensive-Stage Small-Cell Lung Cancer (ES SCLC)
Product: Olaparib, ETOPOSIDE TEVA 20 mg/ml, concentrato per soluzione per infusione, Cisplatino Sandoz 1 mg/ml – Concentrato per soluzione per infusione, KEYTRUDA 25 mg/mL concentrate for solution for infusion, Olaparib, CARBOPLATINO TEVA 10 mg/ml

Primary endpoint: Progression-free Survival (PFS)
Endpoint(s): Objective response rate (ORR) and Immune-related objective response rate (irORR), Progression-free survival (PFS) at 6, 12 and 24 months, Overall Survival (OS), Safety profile

Source: https://euclinicaltrials.eu/ctis-public/view/2024-514666-39-00